EU clinical trial 2023-504761-23-00: A Phase 3, Randomized, Open-Label Study of Nivolumab Combined with Ipilimumab Versus Sunitinib Monotherapy in Subjects with Previously Untreated, Advanced or Metastatic Renal Cell Carcinoma
Protocol code: CA209-214
Sponsor: Bristol Myers Squibb International Corporation (Pharmaceutical company). Phase: Therapeutic confirmatory (Phase III). Countries: Germany (ended), Ireland (ended), Hungary (ended), Austria (ended), Spain (ended), Netherlands (ended), Finland (ended), Czechia (ended), Denmark (ended), Sweden (ended), Belgium (ended), Italy (ended), France (ended).
Therapeutic area(s): Diseases [C] - Neoplasms [C04]
Gender: Female, Male. Age: 18-64 years, 65+ years. Enrolment: 578.
Status: Ended. Start date (EU): 2014-11-19. End date (EU): 2025-01-14. End date: 2025-03-21. Decision date: 2023-08-31. Results received: Yes. Last updated: 2024-12-09.
Decision dates by country: NL: 2023-09-07, HU: 2023-08-31, ES: 2023-09-04, BE: 2023-08-31, FI: 2023-08-31, AT: 2023-09-04, SE: 2023-08-31, IT: 2023-09-18, DK: 2023-09-01, CZ: 2023-08-31, FR: 2023-09-29, IE: 2023-09-05, DE: 2023-09-05

Condition(s): Advanced or metastatic renal cell carcinoma
Product: OPDIVO 10 mg/mL concentrate for solution for infusion., Sutent 12.5 mg hard capsules, Sutent 12.5 mg hard capsules, Ipilimumab

Primary endpoint: The primary endpoints are overall survival and progression free survival
Endpoint(s): Overall survival, Objective response rate, Duration of objective response, Overall safety and tolerability, Disease related symptom progression, Health related quality of life, Healthcare resource utilization, Adverse Event Incidence Rate, Progression-free survival

Source: https://euclinicaltrials.eu/ctis-public/view/2023-504761-23-00